EU clinical trial 2024-511976-34-00: A Phase 1/2, Multi-Center, Open-Label Study to Evaluate the Safety, Tolerability, and Preliminary Anti-tumor Activity of TNG908 in Patients with MTAP-deleted Advanced or Metastatic Solid Tumors
Protocol code: TNG908-C101
Sponsor: Tango Therapeutics Inc. (Pharmaceutical company). Phase: Phase I and Phase II (Integrated)- First administration to humans. Countries: France (ended).
Therapeutic area(s): Diseases [C] - Neoplasms [C04]
Gender: Female, Male. Age: 18-64 years, 65+ years. Enrolment: 50.
Status: Ended. Start date (EU): 2022-10-31. End date (EU): 2025-11-19. End date: 2025-12-30. Decision date: 2024-10-03. Results received: Yes. Last updated: 2025-07-24.

Condition(s): "Ph1: •Locally advanced (LA) or metastatic MTAP-deleted (met.MTAP-del.) solid tumors; •MTAP-del.relapsed or refrac. Grade 4 astrocytoma or glioblastoma multiforme (R/R GBM) Ph2: A1:LA or met.MTAP-del. squamous and nonsquamous NSCLC A2:LA or met.MTAP-del. mesothelioma; A3:LA or met.MTAP-del. sarcoma A4:LA or met.MTAP-del. pancreatic ductal adenocarcinoma or adenosquamous carcinoma w/predominantly adenocarcinoma histology A5:Other LA or met.MTAP-del. solid tumors; A6:MTAP-del. R/R GBM"
Product: TNG908, TNG908, TNG908, TNG908, MIDAZOLAM

Primary endpoint: Phase 1: Incidence of DLTs within the first 28 days of treatment with TNG908 monotherapy Phase 2: - ORR (CR + PR) as determined by RECIST v1.1, mRECIST v1.1, or modified RANO criteria per investigator assessment - DOR as determined by RECIST v1.1, mRECIST v1.1, or modified RANO criteria per investigator assessment, - PFS by investigator assessment - CBR (CR + PR + stable disease) at 16 weeks
Endpoint(s): "Secondary – Phases 1 and 2 - Type, frequency, severity, timing, and relationship to study treatment of any AEs, SAEs, and changes in vital signs, ECGs, ECOG performance status or Karnofsky performance status, and safety laboratory tests - PK parameters of TNG908 including, but not limited to, Cmax, Tmax, AUC0-t, AUC0-∞, t1/2, λz, CL/F, Vz/F, Rac for Cmax and AUC, and Ctrough - Changes in SDMA levels in tumor after dosing with TNG908 "

Source: https://euclinicaltrials.eu/ctis-public/view/2024-511976-34-00